EU clinical trial 2024-516350-22-00: An Open-Label, Single-Arm, Phase 2 Study to Evaluate the Safety, Pharmacokinetics, and Biologic Activity of Pegcetacoplan in Pediatric Patients with Paroxysmal Nocturnal Hemoglobinuria
Protocol code: APL2-PNH-209
Sponsor: Apellis Pharmaceuticals Inc. (Pharmaceutical company). Phase: Therapeutic exploratory (Phase II). Countries: Spain (authorised, recruiting), Netherlands (authorised, recruiting).
Therapeutic area(s): Diseases [C] - Hemic and Lymphatic Diseases [C15]
Gender: Female, Male. Age: 0-17 years. Enrolment: 4.
Status: Authorised, recruiting. Start date (EU): 2021-10-22. Decision date: 2024-09-12. Results received: No. Last updated: 2026-08-04.
Decision dates by country: NL: 2024-09-12, ES: 2024-09-13

Condition(s): Paroxysmal Nocturnal Hemoglobinuria
Product: ASPAVELI 1 080 mg solution for infusion, ASPAVELI 1 080 mg solution for infusion, ASPAVELI 1 080 mg solution for infusion, ASPAVELI 1 080 mg solution for infusion

Primary endpoint: Pharmacokinetics: Pegcetacoplan concentrations and PK parameters over the course of the 16-week treatment period, Efficacy and Pharmacodynamics: Change from baseline to Week 16 in Hb level, Efficacy and Pharmacodynamics: Change from baseline to Week 16 in LDH level, Efficacy and Pharmacodynamics: Change from baseline to Week 16 in ARC, Safety: Incidence and severity of TEAEs over the course of the 16-week treatment period, including bacterial infections
Endpoint(s): Efficacy and Pharmacodynamics: Change from baseline to Week 16 and Week 52 in: − Complement levels (eg, total complement hemolytic activity [CH50], alternative complement pathway hemolytic activity [AH50], and C3 level) − C3 deposition on RBCs − Clonal distribution of PNH RBCs, Efficacy and Pharmacodynamics: Number of transfusions, number of packed RBC units, and total units (mL/kg) transfused over 16 and 52 weeks of treatment with pegcetacoplan, Efficacy and Pharmacodynamics: Occurrence of breakthrough hemolysis over 16 and 52 weeks of treatment with pegcetacoplan, Efficacy and Pharmacodynamics: Change from baseline to Week 52, and from Week 16 to Week 52, in hemoglobin, LDH, and ARC, Efficacy and Pharmacodynamics: Change from baseline to Week 16 and to Week 52 in Health-Related Quality of Life assessments (FACIT-Fatigue and PedsQL General Well-Being Scale), Safety: Incidence of thromboembolic events (major adverse vascular events [MAVE]) over the course of the 16-week treatment period and over 52 weeks of treatment with pegcetacoplan

Source: https://euclinicaltrials.eu/ctis-public/view/2024-516350-22-00